EU clinical trial 2023-507652-76-00: Accelerated treatment of infectious endocarditis
Sponsor: Region Skane (Hospital/Clinic/Other health care facility). Phase: Phase III and phase IV (Integrated). Countries: Sweden (ongoing, recruiting).
Therapeutic area(s): Diseases [C] - Bacterial Infections and Mycoses [C01]
Gender: Female, Male. Age: 18-64 years, 65+ years. Enrolment: 50.
Status: Ongoing, recruiting. Start date (EU): 2022-01-02. Decision date: 2024-10-17. Results received: No. Last updated: 2024-10-17.

Condition(s): Infectious endocarditis
Product: Vancomycin Viatris 1 000 mg pulver till infusionsvätska, lösning, Meropenem Fresenius Kabi 1 g pulver till injektionsvätska eller infusionsvätska, lösning, Ceftriaxon Fresenius Kabi 2 g pulver till infusionsvätska, lösning, Bensylpenicillin Meda 3 g pulver till injektions/infusionsvätska, lösning, Doktacillin 1g respektive 2 g pulver till injektions/infusionsvätska, lösning, Cloxacillin Stragen 2 g pulver till injektions-/infusionsvätska, lösning, Cefotaxim Stragen 1 g pulver till injektions- och infusionsvätska, lösning, Cubicin 350 mg powder for solution for injection or infusion

Primary endpoint: The primary outcome is combined and consists of the following events within 6 months after randomization: a. Death. b. Septic embolization. c. Bacteraemia with the same microorganism. d. Heart surgery not planned at the time of randomization.
Endpoint(s): a. Expenses related to hospital care and other treatment of the condition. b. Length of hospital stay. c. Length of antibiotic tratment. d. Complications related to intravenous access.

Source: https://euclinicaltrials.eu/ctis-public/view/2023-507652-76-00